EU clinical trial 2024-515950-25-00: Open, randomized, IInd phase clinical study evaluating the safety and efficacy of rapamycin in the treatment of drug-resistant epilepsy in children with rare and ultra rare diseases of the central nervous system associated with the activation of the mTOR pathway : BraimTOR-NEURO
Protocol code: BraimTOR-NEURO
Sponsor: Instytut Pomnik Centrum Zdrowia Dziecka (Hospital/Clinic/Other health care facility). Phase: Therapeutic exploratory (Phase II). Countries: Poland (ended).
Therapeutic area(s): Diseases [C] - Nervous System Diseases [C10]
Gender: Female, Male. Age: 0-17 years. Enrolment: 50.
Status: Ended. Start date (EU): 2023-06-27. End date (EU): 2025-12-03. Decision date: 2025-01-11. Results received: Yes. Last updated: 2025-01-11.

Condition(s): epilepsy, mTORopathies, focal cortical dysplasia, LEATS
Product: Rapamune 1 mg/mL oral solution

Primary endpoint: The primary safety endpoint of rapamycin will be the assessment of the incidence of adverse reactions (according to the CTCAE classification) during the treatment phase and follow-up of patients with drug-resistant epilepsy. The primary efficacy endpoint will be the proportion of patients achieving a ≥50% reduction in seizures.
Endpoint(s): A secondary safety endpoint will be the CTCAE severity of adverse reactions and the number of patients experiencing adverse reactions requiring exclusion from the study or premature termination of participation during the therapeutic dose period. The effect of treatment on the results of laboratory tests will also be analyzed. The secondary endpoint of the trial will be maintenance of short-term effects, improvement of quality of life in ≥50% of patients / families

Source: https://euclinicaltrials.eu/ctis-public/view/2024-515950-25-00